EU clinical trial 2023-508208-40-00: Short versus long antiplatelet therapy after TAVI
Sponsor: Centre Hospitalier Universitaire De Caen Normandie (Hospital/Clinic/Other health care facility). Phase: Phase II and Phase III (Integrated). Countries: France (ongoing, recruiting).
Therapeutic area(s): Diseases [C] - Cardiovascular Diseases [C14]
Gender: Female, Male. Age: 18-64 years, 65+ years. Enrolment: 1400.
Status: Ongoing, recruiting. Start date (EU): 2024-11-21. Decision date: 2024-03-22. Results received: No. Last updated: 2026-04-17.

Condition(s): All adult patients with successful transfemoral trans-aortic valve implantation (TAVI ) for symptomatic aortic stenosis (AS) with no other indication for long term antiplatelet or anticoagulant therapy
Product: ASPIRINE PROTECT 100 mg, comprimé gastro-resistant, KARDEGIC 75 mg, poudre pour solution buvable en sachet-dose

Primary endpoint: Net clinical benefit defined by the composite of all cause death, type 1 myocardial infarction, NeuroARC types 1a, 1aH, 1b, 1c, 1d ischemic or hemorrhagic central nervous system (CNS) injury and non-procedure-related major or disabling bleeding VARC types 2 or 3 12 months after successful TAVI
Endpoint(s): • Any non-procedure-related bleeding defined by the VARC classification 1 to 4, • Major or disabling or life threatening bleeding defined by VARC classification 2 or 3, • Major cardiovascular events defined by the composite of all cause death, myocardial infarction based on the universal definition or stroke defined by NeuroARC types 1a, or 1d ischemic CNS injury, • Type 1 VARC classification bleeding, • Type 2 VARC classification bleeding, • Type 3 VARC classification bleeding, • Fatal bleeding defined by Type 4 VARC classification, • Death, • Cardiovascular death, • Type 1 myocardial infarction based on the universal definition, • Stroke defined by NeuroARC types 1a, or 1d ischemic CNS injury, • Intracranial bleeding defined by NeuroARC type 1aH, 1b, 1c hemorrhagic CNS injury, • Transient cerebral ischemic attack defined by NeuroARC type 3a, • Any hospitalization, • Cardiovascular hospitalization, • VARC-defined prosthetic valve thrombosis, • VARC-3 defined Cardiovascular hospitalization, • Death at 2 years (national mortality database)

Source: https://euclinicaltrials.eu/ctis-public/view/2023-508208-40-00